EU clinical trial 2023-503170-20-01: A Phase I Study of VVD-133214 Alone and in Combination in Participants with Advanced Solid Tumors
Protocol code: VVD-133214-01
Sponsor: Vividion Therapeutics Inc. (Pharmaceutical company). Phase: Human Pharmacology (Phase I)- First administration to humans. Countries: Denmark (ongoing, recruiting), Spain (ongoing, recruiting), Belgium (ongoing, recruiting), France (ongoing, recruiting).
Therapeutic area(s): Diseases [C] - Neoplasms [C04]
Gender: Female, Male. Age: 18-64 years, 65+ years. Enrolment: 80.
Status: Ongoing, recruiting. Start date (EU): 2024-02-26. Decision date: 2024-02-22. Results received: No. Last updated: 2026-05-25.
Decision dates by country: FR: 2024-02-27, DK: 2024-02-29, ES: 2024-02-22, BE: 2024-02-26

Condition(s): Advanced solid tumors

Source: https://euclinicaltrials.eu/ctis-public/view/2023-503170-20-01